EU clinical trial 2024-517283-28-00: T-Guard against Autoreactive T cells in Systemic sclerosis: Erasion and Resolution (TASER)
Protocol code: PHIL_TG01
Sponsor: Philikos B.V. (Pharmaceutical company). Phase: Phase I and Phase II (Integrated)- Other. Countries: Netherlands (ongoing, recruiting).
Therapeutic area(s): Diseases [C] - Skin and Connective Tissue Diseases [C17]; Diseases [C] - Immune System Diseases [C20]
Gender: Female, Male. Age: 18-64 years, 65+ years. Enrolment: 13.
Status: Ongoing, recruiting. Start date (EU): 2025-04-29. Decision date: 2025-02-10. Results received: No. Last updated: 2026-04-14.

Condition(s): diffuse cutaneous systemic sclerosis
Product: T-Guard

Primary endpoint: Incidence of Grade 3 or higher adverse events (AEs), based on CTCAE v5, occurring in the period from the first T-Guard infusion until 28 days after the last T-Guard administration.
Endpoint(s): Incidence of AEs occurring during 180 days after treatment start, Incidence of infectious AEs occurring during 180 days after treatment start, Incidence of SAEs occurring during 180 days after treatment start, and - if considered related to T-Guard treatment - occurring in the period of 180 until 365 days after treatment start, Incidence of AESIs occurring during 180 days after treatment start, and - if considered related to T-Guard treatment - occurring in the period of 180 until 365 days after treatment start: hypoalbuminemia; thrombocytopenia; microangiopathy., All-cause mortality during 365 days after treatment start, Immunogenicity of T-Guard, Pharmacokinetics of T-Guard, Achieving revised CRISS-25 scores at study day 90, 180, 270 and 365 compared to baseline., Achieving revised CRISS-50 scores at study day 90, 180, 270 and 365 compared to baseline., Achieving revised CRISS-75 scores at study day 90, 180, 270 and 365 compared to baseline., Achieving revised CRISS-100 scores at study day 90, 180, 270 and 365 compared to baseline., mRSS at study day 36, 90, 180, 270 and 365 compared to baseline., Pulmonary function test results (FVC and DLCO % predicted) at study day 180 and 365 compared to baseline., HRCT quantification at at study day 180 and 365 compared to baseline., Other patient reported measures of function and Quality of Life questionnaires: SHAQ, SF-36, UCLA SCTC GIT 2.0 and EQ5d at study day 36, 90, 180, 270 and 365 compared to baseline., Organ worsening as defined in Step 1 of the revised CRISS- 25 score during 365 days after treatment start.

Source: https://euclinicaltrials.eu/ctis-public/view/2024-517283-28-00